EU clinical trial 2024-517281-42-00: An Open-label, Multi-center, Phase I/II Study of ECI830 as a Single Agent and in Combination With Ribociclib and Endocrine Therapy in Patients With Advanced Hormone Receptor Positive, HER2-negative Breast Cancer and Advanced Solid Tumors
Protocol code: CECI830A12101
Sponsor: Novartis Pharma AG (Pharmaceutical company). Phase: Phase I and Phase II (Integrated)- First administration to humans. Countries: Italy (ongoing, recruiting), Czechia (ongoing, recruiting), Germany (authorised, recruiting), France (ongoing, recruiting), Spain (ongoing, recruiting), Denmark (authorised, recruiting).
Therapeutic area(s): Diseases [C] - Neoplasms [C04]
Gender: Female, Male. Age: 18-64 years, 65+ years. Enrolment: 59.
Start date (EU): 2025-11-12. Decision date: 2025-07-29. Results received: No. Last updated: 2026-03-03.
Decision dates by country: CZ: 2025-07-29, DE: 2025-07-30, ES: 2025-07-30, DK: 2025-07-29, IT: 2025-07-30, FR: 2025-08-01

Condition(s): Advanced solid tumors, Advanced HR+/HER2- breast cancer
Product: LEUPRORELIN ACETATE, FULVESTRANT, ECI830, GOSERELIN, LEUPRORELIN ACETATE, GOSERELIN, RIBOCICLIB, ECI830, ECI830

Primary endpoint: Phase I: Safety – Incidence and severity of dose-limiting toxicities (DLTs), adverse events (AEs) and serious adverse events (SAEs), including changes in lab values, vital signs, electrocardiograms (ECGs). Tolerability – Frequency of dose interruptions, reductions, discontinuations., Phase II: Progression Free Survival (PFS) rate 6 months per local response evaluation criteria in solid tumors (RECIST v1.1).
Endpoint(s): Phase I: Plasma concentrations of ECI830, ribociclib, and derived PK parameters including area under the curve (AUC) and maximum plasma concentration (Cmax). Overall response rate (ORR), best overall response (BOR), disease control rate (DCR), clinical benefit rate (CBR) and PFS per local RECIST v1.1., Phase II: ORR, BOR, PFS, DCR, CBR, duration of response (DOR) as per local RECIST v1.1, and overall survival (OS). Safety - Incidence and severity of AEs, SAEs, including changes in lab values, vital signs, ECGs. Tolerability: Frequency of dose interruptions, reductions, and discontinuations. Plasma concentration of ECI830, ribociclib, and derived PK parameters including AUC and Cmax.

Source: https://euclinicaltrials.eu/ctis-public/view/2024-517281-42-00